EU clinical trial 2024-520196-27-00: A phase Ib, open-label, ascending dose study to assess safety, tolerability and pharmacokinetics of PIT565 in participants with rheumatoid arthritis (RA)
Protocol code: CPIT565C12101
Sponsor: Novartis Pharma AG (Pharmaceutical company). Phase: Human Pharmacology (Phase I)- Other. Countries: Bulgaria (temporarily halted), Romania (temporarily halted), France (authorised, recruitment pending), Germany (temporarily halted), Spain (temporarily halted), Netherlands (authorised, recruitment pending), Hungary (temporarily halted).
Therapeutic area(s): Diseases [C] - Immune System Diseases [C20]
Gender: Female, Male. Age: 18-64 years, 65+ years. Enrolment: 40.
Start date (EU): 2025-10-01. Decision date: 2025-07-22. Results received: No. Last updated: 2026-04-01.
Decision dates by country: FR: 2025-07-22, DE: 2025-07-22, HU: 2025-07-23, RO: 2025-07-28, ES: 2025-07-24, NL: 2025-07-22, BG: 2025-07-25

Condition(s): Rheumatoid Arthritis

Source: https://euclinicaltrials.eu/ctis-public/view/2024-520196-27-00